EU clinical trial 2024-516653-44-00: A Phase 3, Randomized, Multi-center, Open-label Study of Trastuzumab Deruxtecan (T-DXd) versus Investigator's Choice Chemotherapy in HER2-Low, Hormone Receptor Positive Breast Cancer Patients whose Disease has Progressed on Endocrine Therapy in the Metastatic Setting (DESTINY-Breast06)
Protocol code: D9670C00001
Sponsor: AstraZeneca AB (Pharmaceutical company). Phase: Therapeutic confirmatory (Phase III). Countries: Spain (ongoing, recruitment ended), Denmark (ongoing, recruitment ended), Sweden (ongoing, recruitment ended), Netherlands (ended), France (ongoing, recruitment ended), Italy (ongoing, recruitment ended), Germany (ongoing, recruitment ended), Portugal (ended), Belgium (ongoing, recruitment ended), Hungary (ongoing, recruitment ended), Poland (ongoing, recruitment ended), Austria (ongoing, recruitment ended).
Therapeutic area(s): Diseases [C] - Neoplasms [C04]
Gender: Female, Male. Age: 18-64 years, 65+ years. Enrolment: 250.
Start date (EU): 2020-11-30. Decision date: 2024-09-04. Results received: No. Last updated: 2026-06-03.
Decision dates by country: PT: 2024-09-11, HU: 2024-09-09, NL: 2024-09-05, SE: 2024-09-04, DE: 2024-09-16, AT: 2024-10-20, DK: 2024-09-10, ES: 2024-09-09, FR: 2024-09-05, PL: 2024-09-10, BE: 2024-09-04, IT: 2024-09-23

Condition(s): HER2-Low, Hormone Receptor Positive Breast Cancer which has Progressed on Endocrine Therapy in the Metastatic Setting.
Product: PACLITAXEL, DS-8201a, Abraxane 5 mg/ml powder for dispersion for infusion., CAPECITABINE, CAPECITABINE

Primary endpoint: PFS by BICR according to RECIST 1.1 in the HR+, HER2-low population
Endpoint(s): Overall Survival (OS) - in HR+ HER2-low population, Progression Free Survival (PFS) - in intent to treat (ITT) population (HER2 IHC >0 <1+ and HER2-low), OS - in ITT population (HER2 IHC >0 <1+ and HER2-low), Objective Response Rate (ORR) and Duration of response (DoR) - in HR+, HER-2 low population, PFS by Investigator assessment - in the HR+, HER2-low population, ORR and DoR - in the ITT population, PFS2 by Investigator assessment, time to first subsequent therapy (TFST) and time to second subsequent treatment or death (TSST) - in HR+, HER2-low and the ITT population, Safety and tolerability of T-DXd compared to chemotherapy, The pharmacokinetics (PK) of T-Dxd, Health-related quality of life, Immunogenicity of T-Dxd

Source: https://euclinicaltrials.eu/ctis-public/view/2024-516653-44-00